EU clinical trial 2024-512688-30-00: Evaluation of the effectiveness and safety of ALKACITRAT® on the treatment of functional dyspepsia
Protocol code: UNI-BETAIN
Sponsor: Uni-Pharma Kleon Tsetis Pharmaceutical Laboratories S.A. (Pharmaceutical company). Phase: Therapeutic use (Phase IV). Countries: Greece (ongoing, recruiting).
Therapeutic area(s): Diseases [C] - Digestive System Diseases [C06]
Gender: Female, Male. Age: 18-64 years, 65+ years. Enrolment: 92.
Status: Ongoing, recruiting. Start date (EU): 2025-06-04. Decision date: 2024-07-15. Results received: No. Last updated: 2024-07-15.

Condition(s): Functional Dyspepsia
Product: The placebo has the same composition as the investigational medicinal product alkacitrat effervescent tablet 2 g/tab (with the exception of the active substance), is manufactured by the same manufacturer (uni-pharma kleon tsetis pharmaceutical laboratory s.a) and is not sterile., ALKACITRAT® Αναβράζον δισκίο 2 g/tab

Primary endpoint: Comparison of the percentage of patients with improvement (ΔGOS ≥2) at the end of treatment (visit V1) compared to the baseline visit (V0) between the two treatment groups.
Endpoint(s): Comparison of the percentage of patients who responded to treatment (GOS score ≤2 at visit V1) between treatment groups, Comparison of the change in patients' quality of life based on the NDI-SF index at visit V1 versus baseline visit (V0) between the two treatment groups., Comparison of the change in severity of each symptom (VAS scale) at the end of treatment (visit V1) compared to the baseline visit (V0) between the two treatment groups., Comparison of the percentage of patients in whom there was a decrease in GOS scale score of at least one point at visit V1 compared to the baseline visit (V0) between the two treatment groups., Frequency and type of adverse events during the study.

Source: https://euclinicaltrials.eu/ctis-public/view/2024-512688-30-00